EU clinical trial 2026-525613-31-00: Intravenous iron in the management of drug-resistant restless legs syndrome: a randomized controlled delayed-start trial. IRON-RLS
Protocol code: IRON-RLS
Sponsor: Centre Hospitalier Universitaire De Montpellier (Hospital/Clinic/Other health care facility). Phase: Therapeutic exploratory (Phase II). Countries: France (authorised, recruitment pending).
Therapeutic area(s): Diseases [C] - Nervous System Diseases [C10]
Gender: Female, Male. Age: 18-64 years, 65+ years. Enrolment: 60.
Status: Authorised, recruitment pending. Decision date: 2026-05-29. Results received: No. Last updated: 2026-07-31.

Condition(s): Restless legs syndrome
Product: FERRIC CARBOXYMALTOSE

Primary endpoint: The primary outcome measure is the change in the IRLSSG-Q score between visit V1 (baseline) and visit V3 (3 months after V1).
Endpoint(s): Change in the PLMS index between V1 and V3 in the immediate-treatment group and between V3 and V5 in the delayed-treatment group, Change in other polysomnographic parameters (total sleep time, wake after sleep onset, percentage of slow-wave sleep, and rapid eye movement sleep) between V1 and V3 in the immediate-treatment group and between V3 and V5 in the delayed-treatment group., Serum biological parameters [between V1 and V3 in the immediate-treatment group and between V3 and V5 in the delayed-treatment group] and cerebrospinal fluid (CSF) parameters [at V1 in the immediate-treatment group and at V3 in the delayed-treatment group]: ferritin and transferrin saturation., CSF biological parameters prior to intravenous FCM infusion in the immediate-treatment group (V1) and in the delayed-treatment group (V3): ferritin and transferrin saturation., Clinical response defined as a decrease of ≥3 points in the IRLSSG-Q score between V1 and V3, Change in ESS, ISI, BDI, ASRS, and EQ-5D scores between V1 and V3 in the immediate-treatment group and between V3 and V5 in the delayed-treatment group.

Source: https://euclinicaltrials.eu/ctis-public/view/2026-525613-31-00